EU clinical trial 2023-505138-88-00: MK-7480 Single Ascending Dose Study in Healthy Participants
Protocol code: MK-7480-001
Sponsor: Merck Sharp & Dohme LLC (Pharmaceutical company). Phase: Human Pharmacology (Phase I)- First administration to humans. Countries: Belgium (ended).
Therapeutic area(s): Diseases [C] - Digestive System Diseases [C06]
Gender: Male. Age: 18-64 years. Enrolment: 36.
Status: Ended. Start date (EU): 2023-08-03. End date (EU): 2024-03-27. End date: 2024-03-28. Decision date: 2023-07-19. Results received: No. Last updated: 2024-01-18.

Condition(s): Non-alcoholic steatohepatitis

Source: https://euclinicaltrials.eu/ctis-public/view/2023-505138-88-00